EU clinical trial 2023-505605-16-00: Kidney cancer
Protocol code: ONC001-CL-001
Sponsor: Oncorena AB (Pharmaceutical company). Phase: Phase I and Phase II (Integrated)- First administration to humans. Countries: Sweden (ongoing, recruiting), France (authorised, recruitment pending), Portugal (authorised, recruiting), Spain (authorised, recruiting).
Therapeutic area(s): Diseases [C] - Neoplasms [C04]
Gender: Female, Male. Age: 18-64 years, 65+ years. Enrolment: 105.
Start date (EU): 2024-04-24. Decision date: 2023-06-21. Results received: No. Last updated: 2026-04-24.
Decision dates by country: FR: 2026-02-20, PT: 2026-01-27, ES: 2026-04-24, SE: 2023-06-21

Condition(s): Metastatic Clear Cell Renal Cell Carcinoma (ccRCC) or papillary renal cell carcinoma (pRCC) and with End-Stage Renal Disease (ESRD)

Source: https://euclinicaltrials.eu/ctis-public/view/2023-505605-16-00